EU clinical trial 2025-523739-20-00: A Phase 3, Randomized, Double-Blind, Active-Controlled, Parallel-Group, Multicenter, 12-Week Trial to Evaluate the Efficacy and Safety of Treatment with K-924 HD in Participants with Hypercholesterolemia with Inadequate Response to EU-Marketed Pitavastatin 4 mg
Protocol code: K-924-3.01
Sponsor: Kowa Co. Ltd. (Pharmaceutical company). Phase: Therapeutic confirmatory (Phase III). Countries: Spain (ongoing, recruiting).
Therapeutic area(s): Diseases [C] - Cardiovascular Diseases [C14]
Gender: Female, Male. Age: 18-64 years, 65+ years. Enrolment: 40.
Status: Ongoing, recruiting. Start date (EU): 2026-05-14. Decision date: 2026-04-24. Results received: No. Last updated: 2026-06-19.

Condition(s): Hypercholesterolemia
Product: Livazo 4mg film-coated tablets, K-924 HD Placebo: The same IMP as test drug but no active ingredients., PITAVASTATIN, EU-marketed pitavastatin 4 mg Placebo: The same drug as comparator but no active ingredients, K-924

Primary endpoint: Percent change from baseline in LDL-C (Friedewald formula) at 12 weeks of treatment Note: When TG is ≥400 mg/dL (4.5 mmol/L) or calculated LDL-C (Friedewald formula) is <50 mg/dL (1.3 mmol/L), LDL-C (Friedewald formula) is replaced by LDL-C (direct enzymatic method)., Presence or absence of AEs and ADRs after the administration of IMP
Endpoint(s): 1. Presence or absence of participants achieving LDL-C goals at Week 6 and 12 LDL-C goals - Low or moderate risk: fasting LDL-C of <100 mg/dL (<2.6 mmol) - High risk: fasting LDL-C of <70 mg/dL (<1.8 mmol) - Very high risk: fasting LDL-C of <55 mg/dL (<1.4 mmol), 2. Percent change from baseline in LDL-C (direct enzymatic method), HDL-C (direct enzymatic method), non-HDLC, TC, TG, LDL-C (Friedewald formula)/HDL-C and non-HDLC/HDL-C at Week 6 and 12, 3. Values, change and percent change from baseline in fasting LDL-C (Friedewald formula), LDL-C (direct enzymatic method), HDL-C (direct enzymatic method), non-HDL-C, TC, TG, LDL-C (Friedewald formula)/HDL-C and non-HDLC/ HDL-C at Week 6 and 12, 4. Change and percent change from baseline in ApoB at Week 12 Note: When TG is ≥400 mg/dL (4.5 mmol/L) or calculated LDL-C (Friedewald formula) is <50 mg/dL (1.3 mmol/L), LDL-C (Friedewald formula) is replaced by LDL-C (direct enzymatic method). Regarding Apo B, due to the nature of the examination, it will be treated as an exploratory measure., Measurement values and changes from baseline of physiological and clinical laboratory test values at each timepoint

Source: https://euclinicaltrials.eu/ctis-public/view/2025-523739-20-00